EU clinical trial 2022-502952-30-00: An Open-label, Single-dose, Parallel-group Study to Evaluate the Effect of Hepatic Impairment on the Pharmacokinetics, Safety, and Tolerability of Aticaprant (JNJ-67953964)
Protocol code: 67953964MDD1006
Sponsor: Janssen - Cilag International (Pharmaceutical company). Phase: Human Pharmacology (Phase I)- Other. Countries: Germany (ended).
Therapeutic area(s): Psychiatry and Psychology [F] - Mental Disorders [F03]
Gender: Female, Male. Age: 18-64 years, 65+ years. Enrolment: 32.
Status: Ended. Start date (EU): 2023-08-04. End date (EU): 2024-08-13. End date: 2025-01-22. Decision date: 2023-06-30. Results received: No. Last updated: 2024-09-11.

Condition(s): Healthy Adult Participants

Source: https://euclinicaltrials.eu/ctis-public/view/2022-502952-30-00